EU clinical trial 2024-516798-54-00: Induction and maintenance treatment with PARP inhibitor and immunotherapy in HPV-negative Head and Neck Squamous Cell Carcinoma (HNSCC). PRIME H&N study
Sponsor: Fondazione GONO Plus (Laboratory/Research/Testing facility). Phase: Therapeutic exploratory (Phase II). Countries: Italy (ended).
Therapeutic area(s): Diseases [C] - Neoplasms [C04]
Gender: Female, Male. Age: 18-64 years, 65+ years. Enrolment: 49.
Status: Ended. Start date (EU): 2021-02-08. End date (EU): 2025-12-31. Decision date: 2024-11-11. Results received: No. Last updated: 2026-05-15.

Condition(s): HPV-negative Head and Neck Squamous Cell Carcinoma (HNSCC)
Product: JEMPERLI 500 mg concentrate for solution for infusion, Zejula 100 mg film-coated tablets, Zejula 100 mg film-coated tablets

Primary endpoint: Efficacy: Rate of Major Pathological Response (MPR, i.e. less than 10% viable tumor cells identified on routine hematoxylin and eosin staining in pathological surgical specimen) in patients with locally advanced HNSCC treated with Niraparib + Dostarlimab (TSR-042) in the WoO setting.
Endpoint(s): Safety: Safety stopping rule: the first 6 patients will be evaluated for surgical toxicities graded according to Common Terminology Criteria for Adverse Events (CTCAE) v 5.0 and documented over the 4 weeks period following surgery in order to determine if preoperative study protocol is safe., Once the safety is established total planned enrolment will be completed. Surgical safety in the whole population will be evaluated up to 4 weeks after surgery considering the following: a) postoperative bleeding requiring surgical revision b) delayed wound healing or wound dehiscence c) wound infection d) fistula e) need for secondary surgical interventions (not considered part of institutional standard of care) f) skin loss/flap necrosis including partial or total flap as applicable., • Two-year DFS of the patients enrolled in the trial, defined as the time from treatment assignment to cancer recurrence, second cancer or death from any cause. • radiological response after 6 weeks of treatment evaluated at MRI prior to surgery by: a) RECIST v1.1 using conventional MRI imaging b) Diffusion Weighted Imaging Magnetic Resonance Imaging (DWI MRI), • Safety of the whole treatment and safety of each phase (induction and maintenance) as evaluated in a separate way • correlation between radiological and pathological response; • evaluation of predictive role of baseline genomic expression, salivary markers and radiomic characteristics on response to induction therapy; • change in gene expression in tumor samples after induction therapy;

Source: https://euclinicaltrials.eu/ctis-public/view/2024-516798-54-00